EU clinical trial 2024-518182-10-00: Prophylactic nimodipine treatment for hearing preservation after vestibular schwannoma surgery: a randomized multi-center phase III trial (AkNiPro2)
Protocol code: KKSH155
Sponsor: Martin-Luther-Universitaet Halle-Wittenberg (Educational Institution). Phase: Therapeutic confirmatory (Phase III). Countries: Germany (ended).
Therapeutic area(s): Diseases [C] - Neoplasms [C04]
Gender: Female, Male. Age: 18-64 years, 65+ years. Enrolment: 336.
Status: Ended. Start date (EU): 2021-01-13. End date (EU): 2025-06-10. Decision date: 2024-10-30. Results received: Yes. Last updated: 2024-10-30.

Condition(s): Acoustic schwannoma
Product: Nimotop® S, 10 mg/50 ml, Infusionslösung

Primary endpoint: Postoperative cochlear nerve function measured before discharge according to GR scale 1-3 versus GR 4-5 (binary)
Endpoint(s): Late postoperative cochlear nerve function measured at follow up three to six months after surgery (end of study) according to GR scale 1-3 versus GR 4-5 (binary), Postoperative deterioration of cochlear nerve function of at least one grade according to the GR scale compared with its preoperative function (binary), Late postoperative deterioration of cochlear nerve function of at least one grade according to the GR scale compared with its preoperative function measured at follow up three to six months after surgery (end of study) (binary), Change of pure-tone thresholds (PTA) and speech discrimination score (WRSmax), Comparison between GR-scores and AAOHNS-scores, Intraoperative deterioration of BAEP mean values (amplitudes and latencies), Subjective quality of life / psychosocial impairment assessed by patient’s questionnaires (HHIE, SF-12, PANQOL) before surgery and at follow up three to six months, Anatomical preservation of the cochlear nerve and preservation of wave V (BAEP), Data on the safety and side effects of the medication will be obtained. For this purpose, adverse events are recorded descriptively in both groups and evaluated. Particular attention will be paid to intra and postoperative symptomatic hypotension.

Source: https://euclinicaltrials.eu/ctis-public/view/2024-518182-10-00